EU clinical trial 2022-502045-10-00: A multicentre, randomised, double-blind, placebo-controlled, 12-week parallel-group trial to evaluate the efficacy and safety of oral BP1.7881 in adult patients with moderate-to-severe atopic dermatitis
Protocol code: P20-03
Sponsor: Bioprojet Pharma (Pharmaceutical company). Phase: Therapeutic exploratory (Phase II). Countries: Germany (ended), Poland (ended), France (ended).
Therapeutic area(s): Diseases [C] - Immune System Diseases [C20]
Gender: Female, Male. Age: 18-64 years, 65+ years. Enrolment: 81.
Status: Ended. Start date (EU): 2023-08-11. End date (EU): 2024-06-24. Decision date: 2023-05-31. Results received: Yes. Last updated: 2024-08-06.
Decision dates by country: FR: 2023-07-24, DE: 2023-05-31, PL: 2023-07-24

Condition(s): Atopic dermatitis
Product: matching film-coating placebo tablet

Primary endpoint: Mean change from baseline in EASI score after 12 weeks of treatment with BP1.7881 compared to placebo.
Endpoint(s): Proportion of patients who achieved an Investigator’s Global Assessment (IGA) of clear (0) or almost clear (1) with an improvement from baseline ≥2 points, Proportion of patients who achieved 75% improvement in EASI score, Proportion of patients who achieved 90% improvement in EASI score, Percent change from baseline in peak pruritus numerical rating scale (Peak Pruritus -NRS), Proportion of patients with improvement (reduction) of the Peak Pruritus -NRS ≥4 at all scheduled time points, Mean change in pruritus via the 5-D Pruritus Scale

Source: https://euclinicaltrials.eu/ctis-public/view/2022-502045-10-00